EU clinical trial 2024-513448-26-00: Effects of Digoxin in Modern Heart Failure Treatment
Protocol code: DIG-Mod HF
Sponsor: Unidade Local De Saude De Sao Jose E.P.E. (Hospital/Clinic/Other health care facility). Phase: Therapeutic use (Phase IV). Countries: Portugal (ended).
Therapeutic area(s): Diseases [C] - Cardiovascular Diseases [C14]
Gender: Female, Male. Age: 18-64 years, 65+ years. Enrolment: 50.
Status: Ended. Start date (EU): 2024-10-29. End date (EU): 2026-03-10. Decision date: 2024-09-13. Results received: No. Last updated: 2026-04-07.

Condition(s): Heart Failure
Product: DigiFab® (referred to as DIGIFAB) 40 mg/vial digoxin immune Fab, Powder for solution for infusion, Lanoxin MD 0,125 mg comprimido, Norit Carbomix 50 g granulado para suspensão oral

Primary endpoint: Peak oxygen consumption measured by Cardiopulmonary Exercise Test at 24 weeks., Global Work Index measured by Echocardiography at 24 weeks.
Endpoint(s): Composite of death, hospitalizations, and ventricular arrhythmia from baseline to 24 weeks., KCCQ-12 Score at 24 weeks., Changes in analytical parameters at 24 weeks: NTproBNP, Glomerular filtration rate, urine ratio of albumin/creatinine, C-reactive protein, aldosterone and renin plasma values., Cardiopulmonary exercise test parameters at 24 weeks: Peak oxygenconsumption (percentage of predicted), Oxygen consumption at anaerobic threshold, VE/VCO2 slope, Duration of exercise, Optimal point of ventilation., ECG parameters at 24 weeks: QRS interval., Echocardiography parameters at 24 weeks: Global Constructive Work, Global Wasted Work, Global Work Efficiency, Global Longitudinal Strain, Left Ventricular Ejection Fraction, Right ventricular fractional area change, Free-wall right ventricle longitudinal strain, Left ventricle end-diastolic volume, Left Atrial Reservoir Strain, Mechanical dispersion, E/e´

Source: https://euclinicaltrials.eu/ctis-public/view/2024-513448-26-00